EU clinical trial 2022-501017-31-00: A Phase 3, Randomized, Double-Blind Study Comparing Upadacitinib (ABT-494) to Placebo and to Adalimumab in Subjects with Moderately to Severely Active Rheumatoid Arthritis Who are on a Stable Background of Methotrexate (MTX) and Who Have an Inadequate Response to MTX (MTX-IR)
Protocol code: M14-465
Sponsor: Abbvie Deutschland GmbH & Co. KG (Pharmaceutical company). Phase: Therapeutic confirmatory (Phase III). Countries: Belgium (ongoing, recruitment ended), Portugal (ongoing, recruitment ended), Italy (ended), Bulgaria (ongoing, recruitment ended), France (ongoing, recruitment ended), Spain (ongoing, recruitment ended), Slovakia (ongoing, recruitment ended), Czechia (ongoing, recruitment ended), Romania (ongoing, recruitment ended), Germany (ongoing, recruitment ended), Estonia (ongoing, recruitment ended), Latvia (ongoing, recruitment ended), Greece (ongoing, recruitment ended), Croatia (ongoing, recruitment ended), Lithuania (ongoing, recruitment ended), Hungary (ongoing, recruitment ended), Poland (ongoing, recruitment ended).
Therapeutic area(s): Diseases [C] - Immune System Diseases [C20]
Gender: Female, Male. Age: 18-64 years, 65+ years. Enrolment: 489.
Start date (EU): 2016-05-10. Decision date: 2023-02-03. Results received: No. Last updated: 2026-08-06.
Decision dates by country: SK: 2023-02-06, BG: 2023-02-08, LT: 2023-02-07, PL: 2023-02-13, GR: 2023-02-07, PT: 2023-02-06, RO: 2023-02-08, IT: 2023-02-07, DE: 2023-02-08, BE: 2023-02-03, HR: 2023-02-07, CZ: 2023-02-08, EE: 2023-02-06, FR: 2023-02-08, HU: 2023-02-08, LV: 2023-02-06, ES: 2023-02-03

Condition(s): Rheumatoid arthritis
Product: Humira 40 mg/0.8 ml solution for injection, Humira 40 mg solution for injection in pre-filled syringe, Humira 40 mg solution for injection in pre-filled syringe, Humira 40 mg solution for injection in pre-filled syringe, Humira 40 mg solution for injection in pre-filled syringe, Upadacitinib, Humira 40 mg solution for injection in pre-filled syringe

Primary endpoint: The primary endpoint is the proportion of subjects achieving ACR20 response at Week 12 or the proportion of subjects achieving clinical remission (CR) based on DAS28 (CRP) at Week 12
Endpoint(s): Change from baseline in Disease Activity Score (DAS)28 (C-reactive protein [CRP]) at Week 12, Change from baseline in mTSS at Week 26, Change from baseline in HAQ-DI at Week 12, ACR50 response rate at Week 12 (non-inferiority of upadacitinib versus ADA), Change from baseline in Short Form 36 (SF-36) Physical Component Score (PCS) at Week 12, Proportion of subjects achieving low disease activity (LDA) based on DAS28 [CRP] ≤ 3.2 at Week 12, Proportion of subjects achieving clinical remission (CR) based on DAS28 (CRP) at Week 12, Proportion of subjects achieving LDA based on Clinical Disease Activity Index (CDAI) at Week 12, Change from baseline in morning stiffness at Week 12, Change from baseline in Functional Assessment of Chronic Illness Therapy Fatigue (FACIT-F) at Week 12, ACR50 response rate at Week 12 (superiority of upadacitinib vs. ADA), Change from baseline in Patient's Assessment of Pain at Week 12 (superiority of upadacitinib vs. ADA), Change from baseline in HAQ-DI at Week 12 (superiority of upadacitinib vs. ADA), Other key secondary endpoints (upadacitinib versus placebo): 1) ACR50 response rate at Week 12, 2) ACR70 response rate at Week 12, 3) Proportion of subjects with no radiographic progression (defined as change from baseline mTSS ≤ 0) at Week 26

Source: https://euclinicaltrials.eu/ctis-public/view/2022-501017-31-00